EU clinical trial 2023-506385-30-00: A Phase 1/2, Umbrella Study of the Efficacy and Safety of Pembrolizumab plus Enfortumab vedotin +/- Investigational Agents in First-Line metastatic urothelial carcinoma
Protocol code: MK-3475-04B
Sponsor: Merck Sharp & Dohme LLC (Pharmaceutical company). Phase: Phase I and Phase II (Integrated)- Other. Countries: Netherlands (ended), Spain (ended), Italy (ended), France (ended).
Therapeutic area(s): Diseases [C] - Neoplasms [C04]
Gender: Female, Male. Age: 18-64 years, 65+ years. Enrolment: 49.
Status: Ended. Start date (EU): 2023-05-22. End date (EU): 2026-02-24. Decision date: 2024-02-07. Results received: No. Last updated: 2026-03-17.
Decision dates by country: IT: 2024-02-09, ES: 2024-02-08, NL: 2024-02-07, FR: 2024-02-12

Condition(s): Advanced Urothelial Carcinoma

Source: https://euclinicaltrials.eu/ctis-public/view/2023-506385-30-00